EU clinical trial 2023-503651-10-00: A Phase 1/2 Study of BMS-986340 as Monotherapy and in Combination with Nivolumab or Docetaxel in Participants with Advanced Solid Tumors
Protocol code: CA052-002
Sponsor: Bristol-Myers Squibb Services Unlimited Company (Pharmaceutical company). Phase: Phase I and Phase II (Integrated)- First administration to humans. Countries: Germany (ongoing, recruiting), Spain (ongoing, recruiting), Italy (ongoing, recruiting).
Therapeutic area(s): Diseases [C] - Neoplasms [C04]
Gender: Female, Male. Age: 18-64 years, 65+ years. Enrolment: 163.
Status: Ongoing, recruiting. Start date (EU): 2022-05-17. Decision date: 2023-08-11. Results received: No. Last updated: 2025-12-04.
Decision dates by country: DE: 2023-08-15, IT: 2023-08-16, ES: 2023-08-11

Condition(s): Male and female participants ≥ 18 years of age with advanced or metastatic cancers
Product: Docetaxel-Ebewe, 10 mg/ml, koncentrat do sporządzania roztworu do infuzji, Anti-CCR8 NF mAb, OPDIVO 10 mg/mL concentrate for solution for infusion.

Primary endpoint: Incidence of AEs, SAEs, AEs meeting protocol defined DLT criteria, AEs leading to discontinuation and death
Endpoint(s): Summary measures of PK parameters of BMS-986340 administered as monotherapy and in combination with nivolumab or docetaxel, Incidence of anti-drug antibodies to BMS-986340 when BMS-986340 is administered as monotherapy and in combination with nivolumab or docetaxel, ORR, DCR, DOR, and PFSR

Source: https://euclinicaltrials.eu/ctis-public/view/2023-503651-10-00